EU clinical trial 2023-508884-59-00: ATLAS-OLE: An Open-label, Long-term Safety and Efficacy Study of Fitusiran in Patients with Hemophilia A or B, with or without Inhibitory Antibodies to Factor VIII or IX
Protocol code: LTE15174
Sponsor: Genzyme Corp. (Pharmaceutical company). Phase: Therapeutic confirmatory (Phase III). Countries: Ireland (ended), Denmark (ended), Italy (ended), France (ended), Hungary (ended).
Therapeutic area(s): Diseases [C] - Hemic and Lymphatic Diseases [C15]
Gender: Male. Age: 0-17 years, 18-64 years, 65+ years. Enrolment: 18.
Status: Ended. Start date (EU): 2024-06-03. End date (EU): 2025-11-17. Decision date: 2024-05-17. Results received: No. Last updated: 2025-08-21.
Decision dates by country: FR: 2024-05-17, DK: 2024-05-17, IE: 2024-05-17, HU: 2024-05-21, IT: 2024-05-22

Condition(s): Hemophilia A or Hemophilia B
Product: COAGULATION FACTOR VIII, COAGULATION FACTOR VIIA, COAGULATION FACTOR IX, SAR439774, FACTOR VIII INHIBITOR BYPASSING ACTIVITY, ANTITHROMBIN III

Primary endpoint: Number of participants with treatment emergent adverse events (TEAEs)
Endpoint(s): Annualized bleeding rate in the treatment period., Annualized spontaneous bleeding rate in the treatment period., Annualized joint bleeding rate in the treatment period., Change in haemophilia quality of life questionnaire for adults (HaemAQoL) physical health score in the treatment period (in participants ≥17 years of age).

Source: https://euclinicaltrials.eu/ctis-public/view/2023-508884-59-00